EU clinical trial 2023-510024-79-00: Evaluation of the feasibility of PD L 506 for stereotactic interstitial photodynamic therapy (iPDT) in adult patients with newly diagnosed supratentorial IDH wild-type glioblastoma
Protocol code: GL 01
Sponsor: Photonamic GmbH & Co. KG (Pharmaceutical company). Phase: Therapeutic exploratory (Phase II). Countries: Germany (ended).
Therapeutic area(s): Diseases [C] - Neoplasms [C04]
Gender: Female, Male. Age: 18-64 years, 65+ years. Enrolment: 20.
Status: Ended. Start date (EU): 2021-09-03. End date (EU): 2026-04-09. Decision date: 2024-07-05. Results received: No. Last updated: 2026-04-02.

Condition(s): Glioblastoma
Product: Gliolan 30 mg/ml powder for oral solution.

Primary endpoint: The incidence of treatment-emergent Adverse Events (TEAEs) of CTC grades 3, 4 and 5 within two weeks following iPDT.

Source: https://euclinicaltrials.eu/ctis-public/view/2023-510024-79-00